EU clinical trial 2023-508928-35-00: SHINE trial - Effect of Sildenafil in association to Hypothermia on survival without brain lesions In term Neonates with hypoxic-ischemic Encephalopathy: a randomized, double-blinded, placebo-controlled, multicenter trial
Protocol code: APHP180603
Sponsor: Assistance Publique Hopitaux De Paris (Hospital/Clinic/Other health care facility). Phase: Phase II and Phase III (Integrated). Countries: France (authorised, recruitment pending).
Therapeutic area(s): Diseases [C] - Nervous System Diseases [C10]
Gender: Female, Male. Age: 0-17 years. Enrolment: 556.
Status: Authorised, recruitment pending. Decision date: 2024-11-27. Results received: No. Last updated: 2025-06-27.

Condition(s): Hypoxic ischemic encephalopathy
Product: Revatio 0.8 mg/ml solution for injection

Primary endpoint: Primary endpoint of step 1 will be the measured plasma concentrations of Sildenafil., Primary endpoint of step 2 will be survival without brain lesions at hospital discharge on brain MRI. The MRI will be performed between the end of rewarming (day 3.5) and day 5
Endpoint(s): Step 1: estimated clearance parameters and volumes of distribution for IV sildenafil, Step 1: area under the plasma sildenafil concentration-time curve and the maximum plasma sildenafil concentration achieved (individual exposure), Step 1: brain damage-free survival at hospital discharge on MRIs performed between 3.5 to 5 days and/or 10-30 days” (treatment efficacy), Step 2: Secondary end-points, related to potential benefits, will be based on changes in EEG patterns, detailed analysis of MRIs and spectroscopy, and 2-year assessment (neurodevelopmental impairment, autism spectrum disorders assessed using M-CHAT (Modified Checklist for Autism in Toddlers), PARCA-R and Parenting Stress Index-Short Form (PSI-SF)., Step 2: Secondary end-points, related to safety, will include incidence of low systemic pressure requiring hemodynamic support, and cardiac function assessment.

Source: https://euclinicaltrials.eu/ctis-public/view/2023-508928-35-00